EU clinical trial 2024-517404-11-00: A Randomized, Double-Blind, Multi-Center, Placebo-Controlled, Trial to Evaluate the Efficacy and Safety of Once Daily Diclofenac Gel AMZ001 3.06% in the Treatment of Pain and Symptoms of Knee Osteoarthritis
Protocol code: AMZ001-007
Sponsor: Amzell B.V. (Pharmaceutical company). Phase: Therapeutic confirmatory (Phase III). Countries: Denmark (ended), Czechia (ended), Poland (ended).
Therapeutic area(s): Diseases [C] - Musculoskeletal Diseases [C05]
Gender: Female, Male. Age: 18-64 years, 65+ years. Enrolment: 206.
Status: Ended. Start date (EU): 2025-04-30. End date (EU): 2025-12-10. End date: 2025-12-22. Decision date: 2025-04-29. Results received: Yes. Last updated: 2025-10-07.
Decision dates by country: DK: 2025-04-29, PL: 2025-05-05, CZ: 2025-04-30

Condition(s): Knee Osteoarthritis
Product: Panodil, filmovertrukne tabletter 500 mg (Ny formulering), Matching placebo, AMZ001

Primary endpoint: The primary endpoint of this trial is the change from baseline in WOMAC pain sub-score (questions 1 to 5) in the target knee as evaluated at week 2.
Endpoint(s): Change from baseline in the WOMAC pain sub-score at week 1, in the target knee., Change from baseline in pain at Day 8, Day 7, Day 6, Day 5, Day 4, Day 3, Day 2, and Day 1 using an 11-point Numeric Rating Scale (NRS)., Partial AUCs of the observed change from baseline based on pain recorded at 24 hours, 12 hours, 4 hours and 1 hour after the first drug application using an 11-point Numeric Rating Scale (NRS)., Change from baseline in PGA at weeks 3 and 6, Changes from baseline in the Chronic Pain Sleep Inventory at weeks 3 and 6, Change from baseline in the weekly average of daily pain recorded using an 11-point pain NRS until week 6 in the target knee, Change from baseline in the WOMAC pain sub-score during the trial in the target knee (week, 3, 4 and 6), Change from baseline in the WOMAC function sub-score at during the trial (weeks 1,2, 3,4 and 6)., Change from baseline in the WOMAC total score during the trial (weeks 3 and 6)., Changes from baseline in quality of life as assessed using the EQ-5D-5L at weeks 3 and 6, Proportion of participants meeting the OMERACT-OARSI responder criteria at weeks 3 and 6, Proportion of participants meeting at least a 30 % reduction from baseline in WOMAC pain sub-score at Week 3 and 6., Proportion of participants meeting at least a 50 % reduction from baseline in WOMAC pain sub-score at Week 3 and 6., Time (days) to first use of rescue medication since baseline., Average daily amount of rescue medication taken between visits., Weekly proportion of days with rescue medication use at Weeks 1-6.

Source: https://euclinicaltrials.eu/ctis-public/view/2024-517404-11-00